EU clinical trial 2025-521457-16-00: LIVER AKI: A randomized, open-label trial to evaluate the efficacy of intravenous human albumin administration versus saline solution (NaCl 0.9%) in patients with decompensated cirrhosis and AKI 1B or grater.
Protocol code: LIVER-AKI
Sponsor: Fundacio De Recerca Clinic Barcelona-Institut D’Investigacions Biomediques August Pi I Sunyer (Laboratory/Research/Testing facility). Phase: Therapeutic use (Phase IV). Countries: Spain (ongoing, recruiting).
Therapeutic area(s): Phenomena and Processes [G] - Digestive System and Oral Physiological Phenomena [G10]; Diseases [C] - Digestive System Diseases [C06]
Gender: Female, Male. Age: 18-64 years, 65+ years. Enrolment: 114.
Status: Ongoing, recruiting. Start date (EU): 2026-04-21. Decision date: 2025-10-29. Results received: No. Last updated: 2025-10-29.

Condition(s): descompensated hepatic cirrosis
Product: HUMAN SERUM ALBUMIN, SODIUM CHLORIDE

Primary endpoint: Analyze the effect of HA versus (NaCl 0.9%) administration on the probability of AKI resolution among patients with decompensated cirrhosis and AKI 1B or greater acute kidney injury (AKI) clinical efficacy of HA versus saline (NaCl 0.9%) administration in patients with AKI 1B or higher will be evaluated, defining AKI resolution as the percentage of patients with a decrease in serum creatinine levels < 0.3 mg/dL with respect to baseline serum creatinine, without the need for TRT.
Endpoint(s): Survival rate at 28 days, considering liver transplantation as a competitive risk event, AKI improvement, defined as the percentage of patients who decrease at least 1 grade of AKI classification (from 3 to 2, from 2 to 1B, and from 1B to 1A or recovery), without the need for RRT, Proportion of patients requiring RRT In both groups, Changes from baseline in systemic inflammatory response, evaluated by measurement in a large array of plasma cytokine levels including, but not limited to TNFα, IL-6, IL8, IL-10, IL-1β, IFN-ɣ, G-CSF, VCAM, VEGF, as well as an oxidized form of albumin, human nonmercaptalbumin-2 (HNA2) at visits 1, 2, 4, 5 and 6, Changes from baseline in different plasma and urine prognostic biomarkers including, but not only, copeptin, NGAL, PD-L1, L-FABP at visits 1, 2, 4, 5 and 6., Changes from baseline in systemic hemodynamics and vasoactive hormones: plasma renin concentration and plasma copeptin at visits 1, 2, 4, 5 and 6,, Changes in echocardiographic parameters (E/E', ITV, among others) at visit 1, 2, 7 and 28., Proportion of patients and severity of treatment-related adverse events during the study period

Source: https://euclinicaltrials.eu/ctis-public/view/2025-521457-16-00